EU clinical trial 2025-521093-34-00: BeCALM - Brentuximab vedotin in CutAneous T-cell Lymphomas (CTCL): post-allogeneic hematopoietic stem cell transplant Maintenance
Protocol code: 2025-521093-34-00
Sponsor: Assistance Publique Hopitaux De Paris (Hospital/Clinic/Other health care facility). Phase: Therapeutic confirmatory (Phase III). Countries: France (authorised, recruitment pending).
Therapeutic area(s): Diseases [C] - Neoplasms [C04]
Gender: Female, Male. Age: 18-64 years, 65+ years. Enrolment: 84.
Status: Authorised, recruitment pending. Decision date: 2025-08-19. Results received: No. Last updated: 2026-03-12.

Condition(s): rare disease
Product: Placebo ADCETRIS ( NaCl 0.9% 100 mL - Injection IV ), ADCETRIS 50 mg powder for concentrate for solution for infusion.

Primary endpoint: The main study endpoint is progression-free survival at 2 years after randomization. Progression/relapse will be defined according to the ISCL/EORTC criteria, and assessed in a double-blind setting.
Endpoint(s): Overall survival (OS), 1-year variation in quality-of-life scores (EORTC- QLQ-C30 & Skindex-29), Cumulative incidence of disease relapse, Cumulative incidence of acute graft-versus-host disease (GVHD), Cumulative incidence of chronic GVHD, Cumulative incidence of non-relapse mortality, 2-year variation in quality-of-life scores (EORTC-QLQ-C30 and Skindex-29), Skin tumour microenvironment at baseline, 3 months and at relapse/progression if any

Source: https://euclinicaltrials.eu/ctis-public/view/2025-521093-34-00